EU clinical trial 2022-503119-40-00: Clinical and ultrasound assessment of the therapeutic response to ixekizumab in psoriatic arthritis dactlylitis; a multicentre, parallel-groups, randomised controlled trial
Protocol code: DACTOS
Sponsor: Azienda Ospedaliera Ordine Mauriziano Di Torino (Hospital/Clinic/Other health care facility). Phase: Therapeutic confirmatory (Phase III). Countries: Italy (authorised, recruitment pending).
Therapeutic area(s): Diseases [C] - Musculoskeletal Diseases [C05]
Gender: Female, Male. Age: 18-64 years, 65+ years. Enrolment: 60.
Status: Authorised, recruitment pending. Decision date: 2025-04-23. Results received: No. Last updated: 2025-04-23.

Condition(s): psoriatic arthritis (PsA)
Product: Taltz 80 mg solution for injection in pre-filled syringe, Metother 50 mg/ml soluzione iniettabile in siringa pre-riempita.

Primary endpoint: 1) To assess the efficacy of ixekizumab monotherapy versus MTX monotherapy in PsA dactylitis 2) To evaluate the degree of response by using the DACTOS score and the change of each sonographic detected elementary lesion of dactylitis in PsA participants

Source: https://euclinicaltrials.eu/ctis-public/view/2022-503119-40-00